EU clinical trial 2023-503289-22-00: An Adaptive Phase 2a/2b, Randomized, Double-Blind, Parallel-Group Study to Investigate the Safety and Efficacy of LY3541860 Compared to Placebo in Slowing the Occurrence of New T1 Gadolinium-Enhancing Lesions in Adult Participants with Relapsing Multiple Sclerosis
Protocol code: J3K-MC-KIAB
Sponsor: Eli Lilly & Co. (Pharmaceutical company). Phase: Therapeutic exploratory (Phase II). Countries: Italy (ended), Lithuania (ended), Germany (ended), Poland (ended), France (ended), Latvia (ended), Slovakia (ended).
Therapeutic area(s): Diseases [C] - Nervous System Diseases [C10]
Gender: Female, Male. Age: 18-64 years. Enrolment: 57.
Status: Ended. Start date (EU): 2024-07-05. End date (EU): 2025-12-15. Decision date: 2024-05-13. Results received: No. Last updated: 2026-01-09.
Decision dates by country: DE: 2024-05-15, LT: 2024-05-14, PL: 2024-05-15, LV: 2024-05-15, IT: 2024-05-14, SK: 2024-05-13, FR: 2024-05-13

Condition(s): Relapsing Multiple Sclerosis
Product: 0.9% sodium chloride, GADOTERIC ACID

Primary endpoint: Cumulative Number of New T1 Gadolinium-Enhancing (GdE) Lesions Cumulative number will be measured by magnetic resonance imaging (MRI) scans

Source: https://euclinicaltrials.eu/ctis-public/view/2023-503289-22-00